EU clinical trial 2024-510757-95-01: A randomized double-blind placebo-controlled trial investigating pain characteristics in response to diclofenac or placebo in symptomatic knee osteoarthritis.
Sponsor: NBCD A/S (Pharmaceutical company). Phase: Therapeutic use (Phase IV). Countries: Denmark (ongoing, recruitment ended).
Therapeutic area(s): Diseases [C] - Musculoskeletal Diseases [C05]
Gender: Female, Male. Age: 18-64 years, 65+ years. Enrolment: 150.
Status: Ongoing, recruitment ended. Start date (EU): 2024-08-01. Decision date: 2024-07-05. Results received: No. Last updated: 2024-09-27.

Condition(s): Knee osteoarthritis
Product: The placebo is mainly made of lactose and starch with no active therapeutic ingredients as 8mm white, round, normal convex tablets and encapsulated in gelatine., Diclofenac Bluefish 50 mg enterotabletter

Primary endpoint: Change from baseline to end of study (EoS) in Knee Injury and Osteoarthritis Outcome Score (KOOS) pain between the active and the placebo group with the PRMS.
Endpoint(s): Change from baseline to EoS in KOOS pain., Change from baseline to EoS in ICOAP constant pain, intermittent pain, and the total ICOAP score., Difference in the observed standard deviation of the change from baseline to EoS in KOOS pain and ICOAP., Changes from baseline to EoS in pressure pain threshold (PPT) at relevant locations, temporal summation of pain (TSP), and conditioned pain modulation (CPM)., Change from baseline to EoS in KOOS function., Change from baseline to EoS in “40-meter walk test”., Change from baseline to EoS in number of placebo responders (≥30% and ≥50%)., Change from baseline to EoS in number of subjects meeting the OMERACT-OARSI responder criteria.

Source: https://euclinicaltrials.eu/ctis-public/view/2024-510757-95-01